EU clinical trial 2024-516545-39-01: Changes in the tumour microenvironment after intravenous or intradermal administration of anti-CTLA-4 in combination with anti-PD1 treatment in patients with melanoma
Protocol code: IpiD
Sponsor: Stichting Amsterdam UMC (Hospital/Clinic/Other health care facility). Phase: Phase I and Phase II (Integrated)- Other. Countries: Netherlands (authorised, recruitment pending).
Therapeutic area(s): Diseases [C] - Neoplasms [C04]
Gender: Female, Male. Age: 18-64 years, 65+ years. Enrolment: 18.
Status: Authorised, recruitment pending. Decision date: 2026-03-18. Results received: No. Last updated: 2026-03-18.

Condition(s): unresectable stage III – IV melanoma
Product: YERVOY 5 mg/ml concentrate for solution for infusion

Primary endpoint: T cell subset frequencies (as percentage of parent), and systemic activation (determined as a 50 % or greater increase in expression of inducible T-cell costimulator (ICOS/CD278)) in PBMCs CD4+/CD8+ T cells at baseline and on-treatment in both groups.
Endpoint(s): Safety of i.d. ipilimumab (group 1 only): Adverse events using Common Terminology Criteria Adverse Events, version 5.0 (CTCAE 5.0), reported as frequency of treatment-related events. Grade 3 or higher will be reported separately.

Source: https://euclinicaltrials.eu/ctis-public/view/2024-516545-39-01